EU clinical trial 2024-519194-19-00: A phase 1/2 multicenter, open-label, dose-escalation study of IDP-121 in patients with relapsed/refractory hematologic malignancies (CASSANDRA)
Protocol code: IDP-121-1
Sponsor: Idp Discovery Pharma S.L. (Pharmaceutical company). Phase: Phase I and Phase II (Integrated)- First administration to humans. Countries: Spain (ongoing, recruiting).
Therapeutic area(s): Diseases [C] - Hemic and Lymphatic Diseases [C15]
Gender: Female, Male. Age: 18-64 years, 65+ years. Enrolment: 62.
Status: Ongoing, recruiting. Start date (EU): 2023-06-06. Decision date: 2024-12-30. Results received: No. Last updated: 2026-06-26.

Condition(s): Any type of B-cell lymphomas, Chronic lymphocytic leukemia (CLL), Multiple myeloma (MM)
Product: IDP-121 Concentrate for solution for infusion 3 mg/mL

Primary endpoint: Maximum tolerated dose (MTD): based on the incidence of DLTs observed at the end of Cycle 1 (28 days)., Recommended phase 2 dose (RP2D): dose used in subsequent Expansion phase. The RP2D will be determined in discussion with the Investigators and the Sponsor based on safety (dose limiting toxicity), PK, PD, and any cumulative toxicity after multiple cycles., Overall response rate (ORR) for CLL, MM and Lymphomas, respectively.
Endpoint(s): Duration of response (DoR), defined as the time from documentation of disease response to disease progression., Time to progression (TTP), time from the first treatment day to objective disease progression; does not include deaths., Progression-free survival (PFS) defined as the interval between the first treatment day to the first sign of disease progression or death from any cause., Event-free survival (EFS) defined as the interval time between the first treatment day to disease progression, death, or discontinuation of treatment from any cause (e.g., toxicity, patient preference, or initiation of a new treatment without documented progression)., Overall survival (OS) defined as the interval between the first treatment day to death from any cause., Safety endpoints: Vital signs, Physical examination, Hematology, Biochemistry, Urinalysis, Electrocardiograms (ECG), All grades AEs and SAEs, Pharmacokinetics parameters: AUClast, Cmax, CL, Css, Ctrough, Ke, t1/2, Tmax, Vd

Source: https://euclinicaltrials.eu/ctis-public/view/2024-519194-19-00